EU clinical trial 2022-502085-24-00: Randomised, crossover bioequivalence clinical trial of edoxaban 60 mg film-coated tablets, after a single oral dose administration to healthy volunteers under fasting conditions.
Protocol code: DC01EDO/1/22
Sponsor: Biohorm S.L. (Pharmaceutical company). Phase: Human Pharmacology (Phase I)- Bioequivalence Study. Countries: Spain (authorised, recruitment pending).
Therapeutic area(s): Diseases [C] - Cardiovascular Diseases [C14]
Gender: Female, Male. Age: 18-64 years. Enrolment: 15.
Status: Authorised, recruitment pending. Decision date: 2022-12-22. Results received: No. Last updated: 2023-09-15.

Condition(s): Edoxaban is used as antithrombotic agents, but it is a bioequivalence trial and the study population is healthy volunteers

Source: https://euclinicaltrials.eu/ctis-public/view/2022-502085-24-00